EU clinical trial 2023-506917-23-00: Randomised, placebo-controlled Phase II proof of concept study of efficacy and safety of a novel rifamycin SV in situ gelling rectal solution administered by enema to patients with mild to moderate left-sided ulcerative colitis
Protocol code: CB-01-35/01
Sponsor: Cosmo Technologies Limited (Pharmaceutical company). Phase: Therapeutic exploratory (Phase II). Countries: Hungary (ongoing, recruitment ended), Romania (ongoing, recruitment ended), Bulgaria (ended), Poland (ongoing, recruitment ended), Lithuania (ended), Latvia (ended), Estonia (ongoing, recruitment ended).
Therapeutic area(s): Diseases [C] - Digestive System Diseases [C06]
Gender: Female, Male. Age: 18-64 years, 65+ years. Enrolment: 150.
Start date (EU): 2024-04-19. Decision date: 2024-02-12. Results received: No. Last updated: 2026-07-08.
Decision dates by country: BG: 2024-03-29, PL: 2024-03-25, EE: 2024-02-12, LT: 2024-02-28, RO: 2024-02-22, HU: 2024-03-27, LV: 2024-03-27

Condition(s): patients with mild to moderate left-sided ulcerative colitis
Product: Rifamycin 1% in situ gelling solution (80 mL) for rectal administration, Rifamycin SV sodium in situ gelling solution matching placebo (80 mL) for rectal administration

Primary endpoint: the proportion of patients achieving clinical remission after 6 weeks of treatment with the test product as compared to the matching placebo. Clinical remission of ulcerative colitis is defined as a total modified Mayo score ≤2 including the following subscores: o Stool frequency subscore ≤1 o Rectal bleeding subscore = 0 o Endoscopy subscore ≤1 (score of 1 without the component “friability”).
Endpoint(s): the proportion of patients in symptomatic remission on Week 6, defined as stool frequency subscore ≤1 AND rectal bleeding subscore = 0 after 6 weeks of treatment with the test product as compared to the matching placebo, the proportion of patients achieving a clinical response after 6 weeks of treatment with the test product as compared to the matching placebo, defined as: - a decrease from baseline in the modified Mayo score by ≥2 points and by at least 30% from baseline, AND - a decrease in rectal bleeding subscore ≥1 or an absolute rectal bleeding subscore of 0 or 1., the proportion of patients achieving endoscopic remission, defined as a centrally read endoscopy subscore of 0, after 6 weeks of treatment with the test product as compared to the matching placebo;, the proportion of patients achieving endoscopic response, defined as a centrally read endoscopy subscore of 0 or 1 (score of 1 modified to exclude friability) after 6 weeks of treatment with the test product as compared to the matching placebo, the proportion of patients with baseline total modified Mayo score ≥5 and ≤7 and achieving clinical remission, safety and general tolerability of the investigational medicinal product will be based on treatment-emergent adverse events, clinical laboratory parameters, vital signs, physical examination findings and ECG results;

Source: https://euclinicaltrials.eu/ctis-public/view/2023-506917-23-00